EU clinical trial 2023-507325-42-00: A Master Protocol for Three, Independent, Seamlessly Enrolling, Double-blind, Placebo-controlled, Efficacy and Safety Studies of ACP-204 in Adults with Alzheimer's Disease Psychosis
Sponsor: Acadia Pharmaceuticals Inc. (Pharmaceutical company). Phase: Therapeutic exploratory (Phase II). Countries: Czechia (ongoing, recruitment ended), France (ongoing, recruitment ended), Bulgaria (ongoing, recruitment ended), Italy (ongoing, recruitment ended), Spain (ongoing, recruitment ended).
Therapeutic area(s): Diseases [C] - Nervous System Diseases [C10]
Gender: Female, Male. Age: 18-64 years, 65+ years. Enrolment: 282.
Status: Ongoing, recruitment ended. Start date (EU): 2024-07-02. Decision date: 2024-05-31. Results received: No. Last updated: 2026-05-14.
Decision dates by country: ES: 2024-06-03, CZ: 2024-06-03, BG: 2024-06-04, IT: 2024-05-31, FR: 2024-06-03

Condition(s): Alzheimer Disease psychosis
Product: Placebo to match ACP-204

Primary endpoint: From baseline to Week 6: 1. Scale for the Assessment of Positive Symptoms-Hallucinations and Delusions subscales (SAPS-H+D) total score change from baseline.
Endpoint(s): From baseline to Week 6: Clinical Global Impression–Severity in the ADP context (CGI-S-ADP) total score change from baseline

Source: https://euclinicaltrials.eu/ctis-public/view/2023-507325-42-00